EU clinical trial 2023-510099-30-00: Prophylactic Anti-aRrhythmic therapy with Amiodarone in critically ill patients admitted for an out-of-hospital Cardiac Arrest with initial shockable rhythm._PARACA
Protocol code: PARACA_P23/08
Sponsor: Centre Hospitalier De Versailles (Hospital/Clinic/Other health care facility). Phase: Therapeutic confirmatory (Phase III). Countries: France (ongoing, recruiting).
Therapeutic area(s): Diseases [C] - Cardiovascular Diseases [C14]
Gender: Female, Male. Age: 18-64 years, 65+ years. Enrolment: 674.
Status: Ongoing, recruiting. Start date (EU): 2025-09-23. Decision date: 2025-01-22. Results received: No. Last updated: 2025-01-22.

Condition(s): Out-of-hospital cardiac arrest with initial shockable rhythm
Product: CORDARONE 150 mg/3 ml, solution injectable en ampoule (IV)

Primary endpoint: The primary endpoint is a composite of 30-day (starting from inclusion) all-cause mortality and occurrence of severe in-hospital ventricular arrhythmia, defined by ventricular fibrillation and/or ventricular tachycardia requiring intervention occurring between inclusion and hospital discharge (or 30-day whichever the sooner).

Source: https://euclinicaltrials.eu/ctis-public/view/2023-510099-30-00